EU clinical trial 2023-509358-72-00: A Phase 3, Randomized, Double-Blind, Placebo-Controlled Study of Acalabrutinib in Combination with Rituximab, Cyclophosphamide, Doxorubicin, Vincristine, and Prednisone (R-CHOP) in Subjects ≤75 Years with Previously Untreated Non-Germinal Center Diffuse Large B-Cell Lymphoma
Protocol code: D8227C00001
Sponsor: Acerta Pharma B.V. (Pharmaceutical company). Phase: Therapeutic confirmatory (Phase III). Countries: Spain (ongoing, recruitment ended), Italy (ongoing, recruitment ended), Belgium (ongoing, recruitment ended), Germany (ongoing, recruitment ended), Portugal (ongoing, recruitment ended), France (ongoing, recruitment ended), Poland (ongoing, recruitment ended), Czechia (ongoing, recruitment ended), Austria (ongoing, recruitment ended).
Therapeutic area(s): Diseases [C] - Neoplasms [C04]
Gender: Female, Male. Age: 18-64 years, 65+ years. Enrolment: 221.
Status: Ongoing, recruitment ended. Start date (EU): 2020-11-23. Decision date: 2024-05-20. Results received: No. Last updated: 2026-06-09.
Decision dates by country: AT: 2024-05-29, BE: 2024-05-22, FR: 2024-05-24, PT: 2024-05-20, PL: 2024-05-31, ES: 2024-05-20, CZ: 2024-05-21, IT: 2024-05-29, DE: 2024-05-24

Condition(s): Diffuse large B-cell lymphoma
Product: RITUXIMAB, Calquence 100 mg hard capsules, Placebo, 100mg hard capsules; Identical to IMP apart from the active substance, DOXORUBICIN, PREDNISONE, VINCRISTINE, CYCLOPHOSPHAMIDE

Primary endpoint: Progression-free survival (PFS) per the Lugano Classification for NHL in Arm A compared to Arm B
Endpoint(s): Investigator-assessed event-free survival (EFS) for NHL in Arm A compared to Arm B, Percentage of Participants Who Achieved a Complete Response (CR) per 2014 Lugano Classification for NHL, Overall survival in Arm A compared to Arm B

Source: https://euclinicaltrials.eu/ctis-public/view/2023-509358-72-00